EU clinical trial 2024-516970-31-00: Molecular imaging exploration of ocular angiogenic activity and evaluation of its value in therapeutic follow-up of AMD patients
Sponsor: Centre Hospitalier Regional De Marseille (Hospital/Clinic/Other health care facility). Phase: Therapeutic exploratory (Phase II). Countries: France (ended).
Therapeutic area(s): Diseases [C] - Eye Diseases [C11]
Gender: Female, Male. Age: 18-64 years, 65+ years. Enrolment: 20.
Status: Ended. Start date (EU): 2022-10-02. End date (EU): 2025-01-04. Decision date: 2024-10-17. Results received: No. Last updated: 2024-10-17.

Condition(s): Age-related macular degeneration
Product: 68Ga-RGD 15MBq/mL prep

Primary endpoint: The PET signal intensity ratios (SUVmax) of the AMD and contralateral eyes at M0 and M4 will be compared by a paired means comparison test.
Endpoint(s): The relationships between PET signal intensity (SUVmax) and retinal thickness measured by OCT, for each eye, will be documented at M0 and M4 respectively by a correlation study., The links between PET signal intensity (SUVmax) and the visual acuity score measured with each of the psychometric scales (ETDRS and Parinaud), for each eye, will be documented at M0 and M4 respectively by a correlation study.

Source: https://euclinicaltrials.eu/ctis-public/view/2024-516970-31-00